EU clinical trial 2025-522054-40-00: A Phase 2, multicenter, open-label study of lifileucel (tumor-infiltrating lymphocytes [TIL]) in participants with previously treated advanced melanoma
Protocol code: IOV-MEL-202
Sponsor: Iovance Biotherapeutics Inc. (Pharmaceutical company). Phase: Therapeutic exploratory (Phase II). Countries: France (ended), Italy (ended), Germany (ended), Spain (ended).
Therapeutic area(s): Diseases [C] - Skin and Connective Tissue Diseases [C17]; Diseases [C] - Neoplasms [C04]
Gender: Female, Male. Age: 18-64 years, 65+ years. Enrolment: 69.
Status: Ended. End date (EU): 2026-03-13. Decision date: 2025-11-26. Results received: No. Last updated: 2026-03-20.
Decision dates by country: IT: 2025-12-01, ES: 2025-11-26, FR: 2025-12-01, DE: 2025-11-27

Condition(s): Previously treated advanced melanoma
Product: PROLEUKIN® 18 x 106 IU Powder for solution for injection or infusion, Lifileucel, Cyclophosphamide Injection 1 g, FLUDARABINE

Primary endpoint: ORR is defined as the proportion of participants who have a confirmed CR or PR per RECIST v1.1 (timeframe: from the date of the lifileucel infusion until disease progression, start of a new anticancer therapy, or death due to any cause, whichever occurs first [up to a maximum of 5 calendar years after the lifileucel infusion]).
Endpoint(s): 1. ORR is defined as the proportion of participants who have a confirmed CR or PR per RECIST v1.1 (timeframe: from the date of the lifileucel infusion until disease progression, start of a new anticancer therapy, or death due to any cause, whichever occurs first [up to a maximum of 5 calendar years after the lifileucel infusion])., 2. CR rate is defined as the proportion of participants who have a confirmed CR per RECIST v1.1 from the date of the lifileucel infusion until disease progression, start of a new anticancer therapy, or death due to any cause, whichever occurs first (up to a maximum of 5 calendar years after the lifileucel infusion)., 3. DOR is measured from the first time that criteria are met for CR or PR per RECIST v1.1 until disease progression or death due to any cause (up to a maximum of 5 calendar years after the lifileucel infusion)., 4. DCR is measured by the percentage of participants with a best overall confirmed response of CR or PR at any time or SD ≥ 4 weeks per RECIST v1.1 from the date of the lifileucel infusion until disease progression, start of a new anticancer therapy, or death due to any cause, whichever occurs first (up to a maximum of 5 calendar years after the lifileucel infusion)., 5. PFS is defined as the time from the date of the lifileucel infusion until disease progression per RECIST v1.1 or death due to any cause (up to a maximum of 5 calendar years after the lifileucel infusion)., 6. OS is the time from the date of the lifileucel infusion to death due to any cause (up to a maximum of 5 calendar years after the lifileucel infusion)., 7. The safety of lifileucel will be characterized by the severity, seriousness, relationship to study intervention, and characteristics of REAE and TEAEs, including SAEs, study intervention-related AEs, and AEs leading to early discontinuation of study intervention or death (event monitoring periods will be defined based on the type of event).

Source: https://euclinicaltrials.eu/ctis-public/view/2025-522054-40-00